EU clinical trial 2025-521673-14-00: An Open-label Multicenter Rollover Study to Provide Continued Treatment to Participants Previously Enrolled in a RVU120 Clinical Study
Protocol code: ROVER-01
Sponsor: Ryvu Therapeutics S.A. (Pharmaceutical company). Phase: Therapeutic exploratory (Phase II). Countries: Spain (authorised, recruitment pending), Poland (ongoing, recruiting), France (ongoing, recruiting), Italy (authorised, recruitment pending).
Therapeutic area(s): Diseases [C] - Neoplasms [C04]
Gender: Female, Male. Age: 18-64 years, 65+ years. Enrolment: 29.
Start date (EU): 2025-12-03. Decision date: 2025-08-27. Results received: No. Last updated: 2026-04-21.
Decision dates by country: ES: 2025-08-27, FR: 2026-01-26, IT: 2026-01-16, PL: 2025-10-15

Condition(s): Relapsed / Refractory Metastatic or Advanced Solid Tumors, Myelofibrosis, Relapsed or Refractory High-Risk Myelodysplastic Syndrome, Acute Myeloid Leukemia with or without NPM1 Mutation
Product: Jakavi 5 mg tablets, Jakavi 15 mg tablets, Jakavi 15 mg tablets, VENETOCLAX, SEL120 monohydrochloride, VENETOCLAX, Jakavi 20 mg tablets, Jakavi 15 mg tablets, Jakavi 5 mg tablets, Jakavi 20 mg tablets, Jakavi 5 mg tablets, VENETOCLAX, SEL120 monohydrochloride, Jakavi 20 mg tablets

Primary endpoint: Incidence and severity of adverse events (AEs) and serious adverse events (SAEs)
Endpoint(s): Time from the first administration of RVU120-based treatment in the parent study until discontinuation of RVU120-based treatment for any reason in the rollover study

Source: https://euclinicaltrials.eu/ctis-public/view/2025-521673-14-00